EU clinical trial 2024-516335-27-00: Rituximab therapy in anti-MAG patients with characteristics of good responders: THERAMAG study
Protocol code: 19PH226
Sponsor: Centre Hospitalier Universitaire De Saint Etienne (Hospital/Clinic/Other health care facility). Phase: Therapeutic confirmatory (Phase III). Countries: France (authorised, recruitment pending).
Therapeutic area(s): Diseases [C] - Nervous System Diseases [C10]
Gender: Female, Male. Age: 18-64 years, 65+ years. Enrolment: 90.
Status: Authorised, recruitment pending. Decision date: 2024-10-25. Results received: No. Last updated: 2025-09-15.

Condition(s): anti-MAG neuropathy
Product: CHLORURE DE SODIUM COOPER 0,9 %, solution injectable, MabThera 500 mg concentrate for solution for infusion

Primary endpoint: Clinical response defined as a 4 points (or more) increase of I-RODS between baseline and 12 months
Endpoint(s): INCAT disability score, 6 minutes walk test, Timed 25 foot walk test, 9 hole peg test, ENMG motor sum score, ENMG sensory sum score, MUNIX sum score, Adverse events, Anti-MAG titre

Source: https://euclinicaltrials.eu/ctis-public/view/2024-516335-27-00